EU clinical trial 2023-508813-18-00: A Phase 2, Global, Multicenter, Long-term Safety Study Designed to Assess the Safety and Tolerability of BHV-7000 in Subjects with Refractory Focal Onset Epilepsy
Protocol code: BHV7000-201
Sponsor: Biohaven Therapeutics Ltd. (Pharmaceutical company). Phase: Therapeutic exploratory (Phase II). Countries: Portugal (ongoing, recruiting), Italy (ongoing, recruiting), Poland (ongoing, recruiting), France (ongoing, recruiting), Belgium (ongoing, recruiting), Spain (ongoing, recruiting), Czechia (ongoing, recruiting), Germany (ongoing, recruiting), Finland (ongoing, recruiting), Austria (ongoing, recruiting), Denmark (ongoing, recruiting), Slovenia (ongoing, recruiting), Croatia (ended), Netherlands (ongoing, recruiting), Romania (ongoing, recruiting), Slovakia (ongoing, recruiting), Greece (ongoing, recruiting), Hungary (ongoing, recruiting).
Therapeutic area(s): Diseases [C] - Nervous System Diseases [C10]
Gender: Female, Male. Age: 18-64 years, 65+ years. Enrolment: 448.
Start date (EU): 2024-12-18. Decision date: 2024-10-07. Results received: No. Last updated: 2026-07-01.
Decision dates by country: RO: 2024-10-14, SI: 2024-10-08, CZ: 2024-10-11, BE: 2024-12-06, AT: 2024-10-14, GR: 2024-10-07, FI: 2024-10-08, NL: 2024-11-06, HR: 2024-10-14, PT: 2024-10-09, SK: 2024-10-07, ES: 2024-10-08, PL: 2024-10-13, DK: 2024-10-07, FR: 2024-10-14, DE: 2024-10-09, HU: 2024-10-11, IT: 2024-10-11

Condition(s): Refractory Focal Onset Epilepsy
Product: BHV-7000, BHV-7000

Primary endpoint: Safety is assessed by the number of unique subjects with deaths, SAE’s, AE’s leading to discontinuation, moderate and severe AEs and grade 3 and 4 laboratory abnormalities

Source: https://euclinicaltrials.eu/ctis-public/view/2023-508813-18-00